EU clinical trial 2024-516008-41-00: Phase I study to evaluate safety and immunogenicity of V-212 in healthy adult volunteers.
Protocol code: VMX-SPN-212-001
Sponsor: Virometix AG (Pharmaceutical company). Phase: Human Pharmacology (Phase I)- First administration to humans. Countries: Belgium (ongoing, recruitment ended).
Therapeutic area(s): Diseases [C] - Bacterial Infections and Mycoses [C01]
Gender: Female, Male. Age: 18-64 years. Enrolment: 60.
Status: Ongoing, recruitment ended. Start date (EU): 2025-01-29. Decision date: 2024-12-10. Results received: No. Last updated: 2026-06-26.

Condition(s): Healthy Volunteers

Source: https://euclinicaltrials.eu/ctis-public/view/2024-516008-41-00